EU clinical trial 2025-524209-34-00: A Randomized, Multi-Center, Double-Blind, Phase III Study Evaluating the Efficacy and Safety of Hetrombopag Olamine Tablets vs Placebo in Patients with Chemotherapy-Induced Thrombocytopenia
Protocol code: SHR8735-303
Sponsor: Jiangsu Hengrui Pharmaceuticals Co. Ltd. (Pharmaceutical company). Phase: Therapeutic confirmatory (Phase III). Countries: France (ongoing, recruiting), Romania (ongoing, recruiting), Poland (authorised, recruitment pending), Spain (ongoing, recruiting), Bulgaria (ongoing, recruiting).
Therapeutic area(s): Not possible to specify
Gender: Female, Male. Age: 18-64 years, 65+ years. Enrolment: 65.
Start date (EU): 2026-05-20. Decision date: 2026-04-21. Results received: No. Last updated: 2026-08-07.
Decision dates by country: RO: 2026-04-22, BG: 2026-04-27, FR: 2026-04-21, PL: 2026-04-23, ES: 2026-04-27

Condition(s): Chemotherapy induced thrombocytopenia
Product: Placebo tablets without active pharmaceutical ingredient closely resembling the imp, Hetrombopag Olamine

Primary endpoint: Part A: PK parameters (e.g., Cmax, AUC0-tau, Cmin) of hetrombopag in non-Asian participants with CIT., Proportion of treatment responders meeting these criteria: 1.) PC ≥100×109 /L within 14 days after initiating IMP treatment (incl Day 14); 2.) Complete two consecutive on-study chemotherapy cycles (C1 and C2) without thrombocytopenia-induced modification of any myelosuppressive agent; 3.) No use of any rescue therapy for thrombocytopenia during the treatment period from the initiation of IP treatment until the end of the primary treatment period.
Endpoint(s): Proportion of participants who completed two consecutive on-study chemotherapy cycles without thrombocytopenia-induced modification of any myelosuppressive agent., Proportion of participants achieving PC ≥100×109 /L without the use of rescue therapy within 14 days after initiating the IP treatment (including Day 14), Proportion of participants with at least a single incidence of rescue therapy., Time to rescue therapy free first platelet response of PC ≥100×109/L defined as the interval between the initiation of IP treatment and the first platelet response., Cumulative duration of platelet response of PC ≥100×109/L without the use of rescue therapy., PC nadir from C1D1 until the end of the primary treatment period., Cumulative duration of severe thrombocytopenia, defined as the number of consecutive days with a PC of ≤50×109/L., Proportion of participants who completed two consecutive on-study chemotherapy cycles without treatment regimen modification., Proportion of participants with all cause events leading to treatment regimen modifications including dose reduction, delay, omission, or discontinuation., Proportion of participants who are free from serious bleeding events, defined as Grade >=2 per the World Health Organization (WHO) bleeding scale, from the initiation of IP treatment until the end of the primary treatment period., Number and proportion of participants with adverse events (AEs)/serious adverse events (SAEs), safety laboratory parameters, vital signs, etc., Proportion of participants with neutropenia during the treatment period from the initiation of IP treatment until the end of the primary treatment period., Proportion of non-Asian treatment responders who meet the following criteria (Part A only): 1) Platelet count (PC) of ≥100×109/L within 14 days after initiating the IP treatment (incl. Day 14); 2) Complete two consecutive on-study chemotherapy cycles (C1 and C2) without thrombocytopenia-induced modification of any myelosuppressive agent; 3) No use of any rescue therapy for thrombocytopenia from the initiation of IP treatment until the end of the primary treatment period.

Source: https://euclinicaltrials.eu/ctis-public/view/2025-524209-34-00